EU clinical trial 2024-510722-10-00: First-in-human, open-label, dose-escalation trial with expansion cohorts to evaluate safety of GEN1047 in subjects with malignant solid tumors
Protocol code: GCT1047-01
Sponsor: Genmab A/S (Pharmaceutical company). Phase: Phase I and Phase II (Integrated)- First administration to humans. Countries: Denmark (ended), Belgium (ended), Netherlands (ended), Spain (ended), France (ended), Poland (ended), Italy (ended).
Therapeutic area(s): Diseases [C] - Neoplasms [C04]
Gender: Female. Age: 18-64 years, 65+ years. Enrolment: 268.
Status: Ended. Start date (EU): 2021-12-13. End date (EU): 2026-03-23. End date: 2026-03-26. Decision date: 2024-05-22. Results received: No. Last updated: 2026-04-01.
Decision dates by country: NL: 2024-05-29, IT: 2024-05-28, BE: 2024-05-22, PL: 2024-05-27, DK: 2024-05-22, FR: 2024-05-27, ES: 2024-05-22

Condition(s): Malignant Solid Tumors
Product: GEN1047 DP

Primary endpoint: Dose Escalation Part: Dose-liming toxicities (DLTs), Dose Escalation Part: Adverse events (AEs) and safety laboratory parameters, Dose Expansion Part: Objective response rate (ORR) based on RECIST v1.1 as assessed by the investigator
Endpoint(s): Dose Escalation Part: PK parameters (clearance; volume of distribution; AUClast; AUCinf; Cmax; Tmax; Ctrough; and t1/2), Dose Escalation Part: Anti-drug antibody (ADA) incidence, Dose Escalation Part: Antitumor activity based on Response Evaluation Criteria in Solid Turmors (RECIST v1.1) as assessed by the investigator: Objective response rate (ORR), Duration of response (DOR), Time to response (TTR), Disease control rate (DCR), Dose Expansion Part: Antitumor activity, based on RECIST v1.1 as assessed by the investigator: DOR, TTR, DCR, Dose Expansion Part: Progression-free survival (PFS) based on RECIST v1.1 as assessed by the investigator; Overall Survival (OS), Dose Expansion Part: AEs and safety laboratory parameters, Dose Expansion Part: PK parameters (clearance; volume of distribution; AUClast; AUCinf; Cmax; Tmax; Ctrough; t1/2), Dose Expansion Part: ADA response

Source: https://euclinicaltrials.eu/ctis-public/view/2024-510722-10-00